EU clinical trial 2024-513774-21-00: AN OPEN-LABEL, MULTICENTER STUDY IN MALE PEDIATRIC PATIENTS WITH CEREBRAL X-LINKED ADRENOLEUKODYSTROPHY (CALD) TO ASSESS THE EFFECTS OF MIN-102 TREATMENT ON DISEASE PROGRESSION PRIOR TO HUMAN STEM CELL TRANSPLANT (HSCT)
Protocol code: MT-2-02
Sponsor: Minoryx Therapeutics S.L. (Pharmaceutical company). Phase: Phase II and Phase III (Integrated). Countries: Germany (ongoing, recruitment ended), France (ongoing, recruitment ended), Spain (ongoing, recruitment ended).
Therapeutic area(s): Diseases [C] - Congenital, Hereditary, and Neonatal Diseases and Abnormalities [C16]
Gender: Male. Age: 0-17 years, 18-64 years. Enrolment: 16.
Status: Ongoing, recruitment ended. Start date (EU): 2019-09-13. Decision date: 2024-06-21. Results received: No. Last updated: 2026-08-04.
Decision dates by country: FR: 2024-06-28, ES: 2024-06-21, DE: 2024-06-25

Condition(s): CEREBRAL X-LINKED ADRENOLEUKODYSTROPHY (CALD)

Primary endpoint: The primary efficacy endpoint will be the number of patients meeting "arrested disease" criteria at Visit 12.
Endpoint(s): Sustained change from Baseline in the score composed of NFS items 1 (hearing/auditory processing), 2 (aphasia/apraxia), 4 (vision impairment), 10 (spastic gait) and 13 (incontinence)., Sustained change from Baseline in total NFS score “Sustained change” is defined as the same total score for NFS items 1, 2, 4, 10, and 13 and no change >1 in NFS total score observed in two the consecutive Visits 6–8, and Visits 11-12, respectively. If “sustained change” definition is not met, the average of the two scores of Visit 6 and 8, and Visit 11 and 12, respectively, will be used. If NFS total score differs by 1 point between V6-8, or V11-12, the higher of the two scores is used., Change from baseline in Loes MRI severity score., Change from baseline in Gadolinium Intensity Score (GIS)., Overall survival of patients who have not undergone HSCT., Number of patients meeting HSCT criteria

Source: https://euclinicaltrials.eu/ctis-public/view/2024-513774-21-00